EU clinical trial 2023-504921-37-00: A Study to Learn About the Study Medicine Called PF-07293893 in Healthy Adults, and How Different Doses of Study Medicine are Tolerated and Act in the Body.
Sponsor: Pfizer Inc. (Pharmaceutical company). Phase: Human Pharmacology (Phase I)- First administration to humans. Countries: Belgium (ended).
Therapeutic area(s): Diseases [C] - Cardiovascular Diseases [C14]
Gender: Female, Male. Age: 18-64 years, 65+ years. Enrolment: 24.
Status: Ended. Start date (EU): 2023-08-04. End date (EU): 2024-03-22. End date: 2024-03-23. Decision date: 2023-06-28. Results received: No. Last updated: 2024-03-04.

Condition(s): heart failure with preserved ejection fraction (HFpEF)

Source: https://euclinicaltrials.eu/ctis-public/view/2023-504921-37-00